EU clinical trial 2024-518583-13-00: PipEracillin Tazobactam versus mERoPENem for treatment of bloodstream infections caused by cephalosporin-resistant Enterobacteriaceae - a non-inferiority randomized controlled trial (PETERPEN)
Protocol code: PETERPEN
Sponsor: Azienda Ospedaliero Universitaria Di Modena (Hospital/Clinic/Other health care facility). Phase: Therapeutic use (Phase IV). Countries: Italy (ongoing, recruiting).
Therapeutic area(s): Diseases [C] - Bacterial Infections and Mycoses [C01]
Gender: Female, Male. Age: 18-64 years, 65+ years. Enrolment: 490.
Status: Ongoing, recruiting. Start date (EU): 2025-11-18. Decision date: 2025-09-03. Results received: No. Last updated: 2025-10-20.
Decision dates by country: IT: 2025-10-20

Condition(s): Patients with bacteremia
Product: Meropenem 2 g powder for solution for injection/infusion, Piperacillina e Tazobactam Aurobindo 2 g/0,25 g polvere per soluzione per infusione

Primary endpoint: Treatment failure at day 7 from randomization. Treatment modifications before day 7 will be discouraged, but they will be allowed according to treating physicians’ discretion
Endpoint(s): •All-cause mortality 14,30,90days •Treatment failure 7,14,30days •Microbiological failure 7,14days •Relapse 30,90days •Clostridium difficile associated diarrhea till 90days •Development of either clinically or microbiologically documented infection other than Gram-negative bacteremia within 90days •Number of hospital re-admissions until day90, •Development of resistance •Carriage of carbapenemase-producing Enterobacteriaceae and non-CPE CRE in-hospital till day90 •Total in-hospital days within 30,90days •Total antibiotic days within 30,90days •Adverse events at 30days

Source: https://euclinicaltrials.eu/ctis-public/view/2024-518583-13-00